EU clinical trial 2024-513827-18-00: PET-imaging of two Vartumabs (F8scFv and C9scFv) in patients with solid tumors – a Phase 0 basket trial
Protocol code: VAR2-2024-CS01
Sponsor: Var2 Pharmaceuticals ApS (Pharmaceutical company). Phase: Human Pharmacology (Phase I)- First administration to humans. Countries: Netherlands (ongoing, recruiting).
Therapeutic area(s): Diseases [C] - Neoplasms [C04]
Gender: Female, Male. Age: 18-64 years, 65+ years. Enrolment: 32.
Status: Ongoing, recruiting. Start date (EU): 2024-11-29. Decision date: 2024-09-24. Results received: No. Last updated: 2025-12-01.

Condition(s): Multiple solid tumors including: colorectal carcinoma (CRC), pancreatic carcinoma, oesophageal or gastric carcinoma, head and neck squamous cell carcinoma (HNSCC), chondrosarcoma or osteosarcoma, bladder carcinoma, lung carcinoma and glioblastoma.

Source: https://euclinicaltrials.eu/ctis-public/view/2024-513827-18-00